EU clinical trial 2023-509451-14-00: As Phase I/II, multi-center, open label study of DYP688 in patients with metastatic uveal melanoma (MUM) and other GNAQ/11 mutant melanomas
Protocol code: CDYP688A12101
Sponsor: Novartis Pharma AG (Pharmaceutical company). Phase: Phase I and Phase II (Integrated)- First administration to humans. Countries: Germany (temporarily halted), Spain (temporarily halted), France (temporarily halted), Netherlands (temporarily halted).
Therapeutic area(s): Diseases [C] - Neoplasms [C04]
Gender: Female, Male. Age: 18-64 years, 65+ years. Enrolment: 27.
Status: Temporarily halted. Start date (EU): 2022-11-01. Decision date: 2024-07-30. Results received: No. Last updated: 2026-02-24.
Decision dates by country: ES: 2024-07-30, FR: 2024-08-09, NL: 2024-07-30, DE: 2024-08-01

Condition(s): Metastatic uveal melanoma, other GNAQ/11 mutant melanomas (e.g. skin or mucosal melanoma)
Product: DYP688

Primary endpoint: Phase I: Incidence and severity of dose limiting toxicities (DLTs) during the first 28 days of treatment., Phase I: Incidence and severity of adverse events (AEs) and serious adverse events (SAEs), including changes in laboratory values, electrocardiograms (ECGs), and vital signs., Phase I: Frequency of dose interruptions, reductions, and discontinuations., Phase II: Overall Response rate (ORR) per RECIST 1.1.
Endpoint(s): Phase I and Phase II: PK parameters for total mAb, conjugated active and inactive payload, and unconjugated active payloads (e.g., AUC, Cmax, CL, half-life)., Phase I: Prevalence and incidence of anti-DYP688 antibodies., Phase I: Best Overall Response (BOR)., Phase I: Overall Response Rate (ORR) per RECIST v1.1., Phase II: Duration of response (DoR), progression free survival (PFS) and DCR per RECIST v1.1., Phase II: Overall survival (OS), Phase II: Incidence and severity of adverse events (AEs) and serious adverse events (SAEs), including changes in laboratory values, electrocardiograms (ECGs), and vital signs., Phase II: Frequency of dose interruptions, reductions, and discontinuations PK parameters for total mAb, conjugated active and inactive payload, and unconjugated active payloads (e.g., AUC, Cmax, CL, half-life)., Phase II: Prevalence and incidence of anti-DYP688 antibodies.

Source: https://euclinicaltrials.eu/ctis-public/view/2023-509451-14-00